EU clinical trial 2022-502531-18-00: A Phase 3, randomised, double-blind, parallel-group, 76-week, efficacy and safety study of BI 456906 administered subcutaneously compared with placebo in participants with overweight or obesity and type 2 diabetes mellitus
Protocol code: 1404-0041
Sponsor: Boehringer Ingelheim International GmbH, Boehringer Ingelheim RCV GmbH & Co. KG, Boehringer Ingelheim Espana S.A. (Pharmaceutical company). Phase: Therapeutic confirmatory (Phase III). Countries: Netherlands (ended), Czechia (ended), Denmark (ended), Spain (ended), Poland (ended), Germany (ended), Greece (ended), Finland (ended), Belgium (ended), Sweden (ended), Hungary (ended).
Therapeutic area(s): Diseases [C] - Nutritional and Metabolic Diseases [C18]
Gender: Female, Male. Age: 18-64 years, 65+ years. Enrolment: 248.
Status: Ended. Start date (EU): 2024-01-18. End date (EU): 2026-03-19. End date: 2026-03-27. Decision date: 2024-01-15. Results received: No. Last updated: 2026-02-12.
Decision dates by country: HU: 2024-05-17, FI: 2024-06-13, BE: 2024-05-17, SE: 2024-06-18, DK: 2024-01-16, ES: 2024-01-17, PL: 2024-01-19, GR: 2024-01-22, CZ: 2024-01-17, DE: 2024-01-18, NL: 2024-01-15

Condition(s): Obesity, Diabetes mellitus type II
Product: BI 456906, Placebo, BI 456906, BI 456906, BI 456906, BI 456906, BI 456906, BI 456906

Primary endpoint: Percentage change in body weight from baseline to Week 76, Achievement of body weight reduction ≥5% (yes/no) from baseline to Week 76
Endpoint(s): Achievement of body weight reduction ≥10% (yes/no) from baseline to Week 76, Achievement of body weight reduction ≥15% (yes/no) from baseline to Week 76, Achievement of body weight reduction ≥20% (yes/no) from baseline to Week 76, Absolute change from baseline to Week 76 in: o Body weight (kg) o HbA1c (%) o Waist circumference (cm) o SBP (mmHg) o “Capacity to Resist” domain score of Eating Behaviour PRO (units on scale) o Eating Behaviour PRO total score (units on scael)

Source: https://euclinicaltrials.eu/ctis-public/view/2022-502531-18-00